EU clinical trial 2022-502732-39-00: Phase 2/3 Randomized Study of Tebentafusp as Monotherapy and in Combination with Pembrolizumab Versus Investigator’s Choice in HLA-A*02:01-positive Participants with Previously Treated Advanced Melanoma (TEBE-AM)
Protocol code: IMCgp100-203
Sponsor: Immunocore Limited (Pharmaceutical company). Phase: Phase II and Phase III (Integrated). Countries: France (ongoing, recruiting), Germany (ongoing, recruiting), Belgium (ongoing, recruiting), Italy (ongoing, recruiting), Poland (ongoing, recruiting), Austria (ongoing, recruiting), Spain (ongoing, recruiting).
Therapeutic area(s): Diseases [C] - Neoplasms [C04]
Gender: Female, Male. Age: 18-64 years, 65+ years. Enrolment: 352.
Status: Ongoing, recruiting. Start date (EU): 2023-09-01. Decision date: 2023-07-19. Results received: No. Last updated: 2026-07-20.
Decision dates by country: ES: 2023-11-21, AT: 2023-11-13, BE: 2023-07-19, DE: 2023-07-20, PL: 2023-07-31, IT: 2023-07-21, FR: 2023-07-24

Condition(s): Previously treated non-ocular advanced melanoma
Product: KIMMTRAK 100 micrograms/0.5 mL concentrate for solution for infusion, PARACETAMOL, KEYTRUDA 25 mg/mL concentrate for solution for infusion, DEXAMETHASONE PHOSPHATE, DEXAMETHASONE, DIPHENHYDRAMINE

Primary endpoint: Overall survival, Substudy Primary end points: Incidence, time to onset, time to intervention and duration of Grade >/= 2 CRS based on ASTCT grade, and incidence of hospitalization and unscheduled medical encounters
Endpoint(s): ctDNA reduction on treatment relative to baseline, Incidence and severity of AEs, SAEs, and changes from baseline in laboratory parameters, vital signs, and ECGs Dose interruptions reductions, dose intensity and discontinuation of all administered agents, Incidence of Grade ≥ 2 CRS based on ASTCT grade, time to onset, duration of defined CRS component events, and incidence of prolonged hospitalization, Patient-reported symptoms and health-related quality of life according to the EORTC-QLQ-C30 and general health status according to the EQ-5D-5L questionnaires., Tebentafusp PK parameters (eg, Cmax, Tmax, Cavg, t1/2), Incidence of anti-tebentafusp antibodies, Substudy Secondary end points: 1. Incidence and severity of AEs, SAEs, and changes from baseline in laboratory parameters, vital signs, and ECGs Dose interruptions and reductions, dose intensity, and discontinuation of all administered agents, 2. OS, 3. Patient-reported symptoms and health-related quality of life according to the EORTC-QLQ-C30 and general health status according to the EQ-5D-5L questionnaires

Source: https://euclinicaltrials.eu/ctis-public/view/2022-502732-39-00